EU clinical trial 2023-507649-27-00: Route of nutrition and muscle wasting after oesophagectomy – a randomised, controlled, observer blind trial
Sponsor: Aarhus Universitet (Educational Institution). Phase: Therapeutic use (Phase IV). Countries: Denmark (authorised, recruitment pending).
Therapeutic area(s): Diseases [C] - Neoplasms [C04]
Gender: Female, Male. Age: 18-64 years, 65+ years. Enrolment: 38.
Status: Authorised, recruitment pending. Decision date: 2024-01-16. Results received: No. Last updated: 2024-02-29.

Condition(s): Oesophagectomy
Product: SmofKabiven emulsion for infusion

Primary endpoint: Mean difference in muscle size assessed by CT-scan from before to 10 days after oesophagostomy

Source: https://euclinicaltrials.eu/ctis-public/view/2023-507649-27-00